EU clinical trial 2024-515911-23-00: A study in healthy men to test whether BI 1815368 influences the amount of metformin in the body
Protocol code: 1485-0013
Sponsor: Boehringer Ingelheim International GmbH (Pharmaceutical company). Phase: Human Pharmacology (Phase I)- Other. Countries: Germany (ended).
Therapeutic area(s): Not possible to specify
Gender: Male. Age: 18-64 years. Enrolment: 14.
Status: Ended. Start date (EU): 2024-11-06. End date (EU): 2025-01-13. Decision date: 2024-10-09. Results received: No. Last updated: 2024-10-09.

Condition(s): Healthy volunteer trial

Source: https://euclinicaltrials.eu/ctis-public/view/2024-515911-23-00